EU clinical trial 2023-503886-44-00: Refining Adjuvant treatment IN endometrial cancer Based On molecular features, TransPORTEC platform trials – p53abn - RED (RAINBO-p53abnRED); Randomized phase III trial testing maintenance olaparib versus observation after adjuvant chemoradiation for p53abn endometrial cancer
Protocol code: CSET 2023/3603
Sponsor: Institut Gustave Roussy (Hospital/Clinic/Other health care facility). Phase: Therapeutic confirmatory (Phase III). Countries: France (ongoing, recruiting).
Therapeutic area(s): Not possible to specify
Gender: Female. Age: 18-64 years, 65+ years. Enrolment: 150.
Status: Ongoing, recruiting. Start date (EU): 2024-06-10. Decision date: 2023-12-12. Results received: No. Last updated: 2025-11-05.

Condition(s): Patients with a histological diagnosis of p53abn HREC, treated with curative intent, after surgery (hysterectomy and bilateral salpingooophorectomy, with or without lymphadenectomy or sentinel node biopsy), without signs of residual disease or distant metastases
Product: Lynparza 100 mg film-coated tablets, Lynparza 150 mg film-coated tablets

Primary endpoint: Recurrence free survival (RFS) in patients with p53abn EC, as assessed by the investigator. RFS is defined as time from randomization until date of any recurrence (local or distant) or date of death due to any cause
Endpoint(s): Overall survival (OS) ,Disease-specific survival , Vaginal recurrence-free survival , Pelvic recurrence-free survival , Distant recurrence-free survival

Source: https://euclinicaltrials.eu/ctis-public/view/2023-503886-44-00